EU clinical trial 2024-514938-20-00: Study to Investigate the Safety and Tolerability of Odronextamab in Patients With CD20+ B-Cell Malignancies
Protocol code: R1979-HM-1333
Sponsor: Regeneron Pharmaceuticals Inc. (Pharmaceutical company). Phase: Human Pharmacology (Phase I)- First administration to humans. Countries: Germany (ended).
Therapeutic area(s): Diseases [C] - Hemic and Lymphatic Diseases [C15]
Gender: Female, Male. Age: 18-64 years, 65+ years. Enrolment: 65.
Status: Ended. Start date (EU): 2016-08-31. End date (EU): 2025-08-21. End date: 2025-08-22. Decision date: 2024-07-08. Results received: No. Last updated: 2025-09-01.

Condition(s): B-cell non-Hodgkin lymphoma (NHL)

Source: https://euclinicaltrials.eu/ctis-public/view/2024-514938-20-00